EU clinical trial 2024-512444-29-00: A prospective, randomized, single blind, multicentre phase III study on organ preservation with Custodiol-N solution compared with Custodiol solution in or-gan transplantation (kidney, liver and pancreas)
Sponsor: Dr. Franz Koehler Chemie GmbH (Pharmaceutical company). Phase: Therapeutic confirmatory (Phase III). Countries: Austria (ongoing, recruiting).
Therapeutic area(s): Analytical,Diagnostic,Therapeutic Techniques and Equipment [E]-Surgical Procedures, Operative [E04]
Gender: Female, Male. Age: 18-64 years, 65+ years. Enrolment: 362.
Status: Ongoing, recruiting. Start date (EU): 2019-05-07. Decision date: 2024-10-22. Results received: No. Last updated: 2026-07-09.

Condition(s): patients who will undergo kidney, liver or kidney-pancreatic transplantation
Product: CUSTODIOL® - Perfusionslösung, Custodiol-N

Primary endpoint: kidney: delayed graft function has been picked as the main endpoint liver: The success of liver transplantation is determined by the area under the curve of GPT (ALT) measurements over the first 7 days after implantation (AUC)
Endpoint(s): Kidney 1. Incidence of primary poor function (creatinine at 3 month: >250 μ mol/l), Kidney 2. Serum creatinine, creatinine MDRD clearance, urea, and hemoglobin after 3 months, kidney 3. Requirement of dialysis until 3 month after transplantation, kidney 4. Biopsy proven rejections, 1. Absolute peak LDH within 7 days after transplantation, liver 2. Moment (day) of peak GPT and peak LDH, liver 3. Serum bilirubin, GOT, GPT, LDH, total albumin and PT at 3 months, liver 4. Biliary complications: number of episodes of cholestasis, therapy for chol-angitis, episodes of biliary leakage and intrahepatic and/or extrahepatic bil-iary strictures, Pancreas 1. Insulin requirements on days 3 and 30 and after 3 months, pancreas 2. α-amylase, lipase, C-reactive protein (CRP) at 1 und 3 days, pancreas 3. C-peptide and HBA1c at day 30 and 3 months, pancreas 4. Pancreatic complications: graft pancreatitis, anastomotic leak, vascular complications (thrombosis, stenosis, bleeding), pancreas 5. Fasting glucose at 3 months

Source: https://euclinicaltrials.eu/ctis-public/view/2024-512444-29-00